EU clinical trial 2025-522627-10-00: Multiple-Dose Bioequivalence of Mirabegron 50 mg Prolonged-Release Tablets in Healthy Participants Under Fasting Conditions.
Protocol code: CFA-1048-3-25
Sponsor: Laboratorios Cinfa S.A. (Pharmaceutical company). Phase: Human Pharmacology (Phase I)- Bioequivalence Study. Countries: Portugal (ended).
Therapeutic area(s): Not possible to specify
Gender: Female, Male. Age: 18-64 years. Enrolment: 48.
Status: Ended. Start date (EU): 2026-04-20. End date (EU): 2026-06-16. Decision date: 2026-03-13. Results received: No. Last updated: 2026-04-16.
Decision dates by country: PT: 2026-04-16

Condition(s): No medical condition.

Source: https://euclinicaltrials.eu/ctis-public/view/2025-522627-10-00